EU clinical trial 2023-505923-30-00: Phase 2, Open label Study of Patritumab Deruxtecan (U3-1402), an Anti-HER3-Antibody Drug Conjugate (ADC), in patients with Advanced Breast Cancer, with biomarker analyses to characterize response to therapy
Protocol code: CSET N° 2020/3188
Sponsor: Institut Gustave Roussy (Hospital/Clinic/Other health care facility). Phase: Therapeutic exploratory (Phase II). Countries: France (ongoing, recruiting).
Therapeutic area(s): Diseases [C] - Neoplasms [C04]
Gender: Female, Male. Age: 18-64 years, 65+ years. Enrolment: 139.
Status: Ongoing, recruiting. Start date (EU): 2021-05-11. Decision date: 2024-08-21. Results received: No. Last updated: 2026-07-20.

Condition(s): Patients with hormone-receptor positive (HR+) and human epidermal growth factor receptor 2 negative (HER2-negative) advanced breast cancer (ABC) who have already received standard therapy for HR+/HER2-negative ABC, including only one line of chemotherapy for advanced/metastatic disease.

Source: https://euclinicaltrials.eu/ctis-public/view/2023-505923-30-00